EU clinical trial 2022-502021-18-00: The 3TR Molecular Pathobiology-Driven Precision Therapy in RA (3TR Precis-The-RA) study
Sponsor: Queen Mary University Of London (Educational Institution). Phase: Therapeutic use (Phase IV). Countries: Belgium (ongoing, recruiting), Spain (ongoing, recruiting), Netherlands (authorised, recruitment pending), Portugal (ongoing, recruiting), Italy (ongoing, recruiting), Germany (authorised, recruitment pending).
Therapeutic area(s): Diseases [C] - Musculoskeletal Diseases [C05]
Gender: Female, Male. Age: 18-64 years, 65+ years. Enrolment: 197.
Start date (EU): 2023-10-12. Decision date: 2023-09-06. Results received: No. Last updated: 2026-08-05.
Decision dates by country: BE: 2023-09-05, NL: 2024-03-15, PT: 2023-09-06, IT: 2023-09-08, ES: 2023-09-07, DE: 2026-08-03

Condition(s): Rheumatoid Arthritis
Product: Kevzara 200 mg solution for injection in pre-filled pen, Enbrel 50 mg solution for injection in pre-filled pen, Kevzara 150 mg solution for injection in pre-filled pen

Primary endpoint: The primary endpoint of the study will be a binary outcome of treatment responder/nonresponder classified using American College of Rheumatology 50 (ACR-50) measure at 12 weeks.
Endpoint(s): Percentage of patients with DAS28(ESR)<3.2 (LDA) at 12 weeks, Percentage of patients with CDAI ≤10 (LDA) at 12 weeks, Percentage of patients with CDAI remission at 12 weeks, Change in HAQ-DI at 12 weeks from baseline, Change in SF-36 at 12 weeks from baseline

Source: https://euclinicaltrials.eu/ctis-public/view/2022-502021-18-00